EU clinical trial 2023-506300-12-00: Effects of extensive Weight loss on Insulin resistance and Lipid-kinetics in people with obesity and fatty liver Disease
Sponsor: Region Midtjylland (Hospital/Clinic/Other health care facility). Phase: Therapeutic use (Phase IV). Countries: Denmark (ended).
Therapeutic area(s): Diseases [C] - Nutritional and Metabolic Diseases [C18]
Gender: Female. Age: 18-64 years. Enrolment: 24.
Status: Ended. Start date (EU): 2023-12-18. End date (EU): 2026-02-26. Decision date: 2023-08-28. Results received: No. Last updated: 2025-04-25.

Condition(s): Obesity, Non-alcoholic Fatty Liver Disease
Product: Wegovy 2.4 mg FlexTouch solution for injection in pre-filled pen

Primary endpoint: Changes in VLDL-TG kinetics 8 months after treatment initiation, when their weight loss has stabilized: I) Changes in relation to the degree of weight loss. II) Changes in relation to the amount of fat in the liver, assessed by MRI-PDFF.
Endpoint(s): Changes between the groups in: I) Hepatic secretion of VLDL-TG particles, II) Glucose kinetics, III) Palmitate kinetics, IV) Circulating lipids, V) Insulin resistance, VI) Inflammatory markers, VII) Gut microbiota and metabolites, VIII) The Fibrosis-4 index (FIB-4), IX) NAFLD fibrosis score (NFS), X) Inflammatory markers in blood, gut, liver, fat, and muscle XI) Histology and gene expression in adipose tissue XII) Muscle mass and muscle structure and in histology and gene expression.

Source: https://euclinicaltrials.eu/ctis-public/view/2023-506300-12-00